EU clinical trial 2023-505900-53-00: A Phase 2, Multicenter, Randomized, Double-Blind, Placebo-controlled Study to Evaluate Efficacy, Safety, Tolerability, and Pharmacokinetics of Budigalimab and/or ABBV-382 in People Living with HIV on Stable Antiretroviral Therapy Undergoing Analytical Treatment Interruption.
Protocol code: M19-965
Sponsor: AbbVie Deutschland GmbH & Co. KG (Pharmaceutical company). Phase: Therapeutic exploratory (Phase II). Countries: Germany (ended), Denmark (ended), Italy (ended), France (ended), Poland (ended), Belgium (ended), Spain (ended).
Therapeutic area(s): Diseases [C] - Virus Diseases [C02]
Gender: Female, Male. Age: 18-64 years, 65+ years. Enrolment: 32.
Status: Ended. Start date (EU): 2024-04-08. End date (EU): 2025-09-08. End date: 2025-09-22. Decision date: 2024-03-21. Results received: No. Last updated: 2025-09-15.
Decision dates by country: DK: 2024-03-25, PL: 2024-03-25, IT: 2024-03-27, ES: 2024-03-22, BE: 2024-03-26, DE: 2024-03-28, FR: 2024-04-25

Condition(s): HIV infection
Product: Budigalimab, Placebo for Budigalimab (ABBV-181) - 0.9% Sodium Chloride or DILUENT, ABBV-382, Placebo for ABBV-382 Solution for Infusion

Primary endpoint: Viral control (viral load < 1000 copies/mL) at Week 24 without ART restart.
Endpoint(s): Peak viral load (at rebound) prior to re-starting ART., Time to first rebound to ≥ 1000 copies/mL during ART interruption.

Source: https://euclinicaltrials.eu/ctis-public/view/2023-505900-53-00